EU clinical trial 2025-523229-16-00: A Phase 2 controlled randomized study of the efficacy of L19IL2 or L19TNF or L19IL2/L19TNF intralesional injections for the treatment of locally advanced basal cell carcinoma patients.
Protocol code: PHL19IL2TNFCOMB04/24
Sponsor: Philogen S.p.A. (Pharmaceutical company). Phase: Therapeutic exploratory (Phase II). Countries: Greece (authorised, recruitment pending), Italy (authorised, recruiting), Germany (ongoing, recruiting), Spain (ongoing, recruiting).
Therapeutic area(s): Diseases [C] - Neoplasms [C04]; Diseases [C] - Skin and Connective Tissue Diseases [C17]
Gender: Female, Male. Age: 18-64 years, 65+ years. Enrolment: 85.
Start date (EU): 2026-04-27. Decision date: 2026-02-10. Results received: No. Last updated: 2026-06-02.
Decision dates by country: DE: 2026-02-11, GR: 2026-02-11, IT: 2026-02-10, ES: 2026-02-16

Condition(s): locally advanced basal cell carcinoma patients
Product: Fibromun, Darleukin

Primary endpoint: The primary objective of the study is to evaluate the efficacy of L19IL2 or L19TNF or L19IL2/L19TNF.

Source: https://euclinicaltrials.eu/ctis-public/view/2025-523229-16-00